EU clinical trial 2022-500744-38-00: Intravenous vs. Intraosseous Vascular Access During Out-of-Hospital Cardiac Arrest – A Randomized Clinical Trial
Protocol code: 2.2
Sponsor: Præhospitalet (Hospital/Clinic/Other health care facility). Phase: Therapeutic exploratory (Phase II). Countries: Denmark (ended).
Therapeutic area(s): Diseases [C] - Cardiovascular Diseases [C14]
Gender: Female, Male. Age: 18-64 years, 65+ years. Enrolment: 1470.
Status: Ended. Start date (EU): 2022-03-01. End date (EU): 2025-05-05. Decision date: 2022-07-04. Results received: Yes. Last updated: 2023-11-20.

Condition(s): Out-of-hospital cardiac arrest (OHCA)
Product: EPINEPHRINE, AMIODARONE

Primary endpoint: Sustained return of spontaneous circulation (ROSC). ROSC is defined as palpable pulses or other signs of circulation without a need for chest compressions. Sustained ROSC means that the patient withholds ROSC >20 min
Endpoint(s): Key secondary outcomes will include survival as well as neurological outcome at 30 days. Neurological outcome will be assessed with the modified Rankin Scale (mRS); scores 0-6 will be presented as counts and percentages, while the outcome will be dichotomized as favorable (mRS 0-3) vs. unfavorable (mRS 4-6).

Source: https://euclinicaltrials.eu/ctis-public/view/2022-500744-38-00